EU clinical trial 2024-512544-27-00: Treatment of vascular stiffness in patients with autosomal dominant polycystic kidney disease
Sponsor: Erasmus Universitair Medisch Centrum Rotterdam (Erasmus MC) (Hospital/Clinic/Other health care facility). Phase: Therapeutic use (Phase IV). Countries: Netherlands (ended).
Therapeutic area(s): Diseases [C] - Congenital, Hereditary, and Neonatal Diseases and Abnormalities [C16]
Gender: Female, Male. Age: 18-64 years, 65+ years. Enrolment: 54.
Status: Ended. End date (EU): 2025-05-16. Decision date: 2024-05-24. Results received: No. Last updated: 2024-05-24.

Condition(s): Autosomal Dominant Polycystic Kidney Disease
Product: Placebo used in this trial is a foodgrade, redried potato starch. It is a white powder with bland taste and free from objectionable odours. Insoluble in water with a temperature below 50 °C and most organic solvents, solution is slightly hazy. The product is intended for use in food., POTATO STARCH, SODIUM CHLORIDE, AMILORIDE

Primary endpoint: The three primary outcomes of this study are the differences in pulse wave velocity (PWV) in high salt versus placebo group, and before versus after amiloride treatment in both groups.
Endpoint(s): Ambulatory (24-hours) blood pressure measurements, Serum markers of inflammation, Other relevant serum markers for inflammation and endothelial dysfunction, 23Na-MRI scans measuring interstitial sodium accumulation in a subgroup of patients, Salt tasting sensitivity

Source: https://euclinicaltrials.eu/ctis-public/view/2024-512544-27-00